EU clinical trial 2023-508514-42-00: Grafalon®therapy within 12 weeks of Type 1 diabetes (T1D) diagnosis in children and young adults to prevent the loss of residual beta cell function: a randomised, double-blind, placebo-controlled dose finding study Acronym: GIRO T1D
Protocol code: GIRO T1D
Sponsor: Institute For Clinical And Experimental Medicine, University Hospital Kralovske Vinohrady (Hospital/Clinic/Other health care facility, Educational Institution). Phase: Therapeutic exploratory (Phase II). Countries: Czechia (ongoing, recruiting).
Therapeutic area(s): Diseases [C] - Nutritional and Metabolic Diseases [C18]
Gender: Female, Male. Age: 0-17 years, 18-64 years. Enrolment: 18.
Status: Ongoing, recruiting. Start date (EU): 2024-06-04. Decision date: 2024-01-11. Results received: No. Last updated: 2026-05-06.

Condition(s): Type 1 diabetes
Product: Grafalon 20 mg/ml koncentrát pro infuzní roztok

Primary endpoint: AUC0-2h for a mixed meal tolerance test (MMTT) stimulated C-peptide concentration-time curve (C-peptideAUC) at 12 months relative to baseline
Endpoint(s): Peak MMTT stimulated C-peptide concentration (C-peptidemax) at months 6, 12 and 24 relative to baseline Change in fasting C-peptide from baseline to months 6 and 12 Change in HbA1c from baseline to month 12 HbA1c at 12 and 24 months Change in fasting plasma glucose from baseline to month 12 Total insulin treatment administered over the period of 12 months calculated as AUC (insulinAUC). Total daily insulin dose per kg at 1, 3, 6 and 12 months Percentage of patients that maintain stimulated pea

Source: https://euclinicaltrials.eu/ctis-public/view/2023-508514-42-00